EU clinical trial 2022-503090-11-00: Efficacy and safety of frontline tislelizumab in patients with de novo Hodgkin lymphoma unsuitable for standard frontline chemotherapy: a phase II, open-label study
Protocol code: FIL_Tisle-HL
Sponsor: Fondazione Italiana Linfomi Onlus (Patient organisation/association). Phase: Therapeutic exploratory (Phase II). Countries: Italy (ongoing, recruiting).
Therapeutic area(s): Diseases [C] - Hemic and Lymphatic Diseases [C15]
Gender: Female, Male. Age: 65+ years. Enrolment: 25.
Status: Ongoing, recruiting. Start date (EU): 2024-05-23. Decision date: 2023-11-16. Results received: No. Last updated: 2026-05-11.

Condition(s): Hodgkin lymphoma
Product: TISLELIZUMAB

Primary endpoint: The primary endpoint of the study is the ORR (the sum of complete response (CR) and partial response (PR) rate).
Endpoint(s): Duration of response (DoR), Progression Free Survival (PFS), Overall Survival (OS), Disease free survival (DFS), Incidence and severity of adverse events occurred during therapy and up to 90 days after treatment and incidence and severity of serious adverse event occurred from the IC signed to the end of the study (LPLV)

Source: https://euclinicaltrials.eu/ctis-public/view/2022-503090-11-00